EU clinical trial 2022-500292-31-00: An adaptive, Phase 2, double-blind, randomized, placebo-controlled, multicenter study to evaluate the safety, tolerability, immunogenicity, and pharmacodynamic effects of ACI-7104.056 in patients with early stages of Parkinson’s disease
Protocol code: ACI-7104-PD-2103
Sponsor: AC Immune S.A. (Pharmaceutical company). Phase: Therapeutic exploratory (Phase II). Countries: Germany (ongoing, recruiting), Spain (ongoing, recruiting).
Therapeutic area(s): Diseases [C] - Nervous System Diseases [C10]
Gender: Female, Male. Age: 18-64 years, 65+ years. Enrolment: 121.
Status: Ongoing, recruiting. Start date (EU): 2023-05-12. Decision date: 2022-10-13. Results received: No. Last updated: 2025-09-17.
Decision dates by country: ES: 2022-10-17, DE: 2022-10-13

Condition(s): Early stages of idiopathic Parkinson's Disease
Product: ACI-7104.056, DaTSCAN 74 MBq/ml solution for injection, Placebo (PBS-ALH02), adjuvanted solution matching the study vaccine formulation

Primary endpoint: Safety and Tolerability: Adverse events; physical and neurological examination results; global assessment of tolerability; vital signs; brain MRI; ectrocardiogram; routine laboratory tests (eg, hematology and biochemistry evaluation) in blood and urine; suicidality as measured with the Columbia Suicide Severity Rating Scale., Immunogenicity: Antibody response induced by the study vaccine.
Endpoint(s): Absolute levels and change from baseline in a-syn related fluid biomarkers, including pathogenic a-syn oligomer species and/or differentially phosphorylated synuclein species, in any collected blood and/or CSF sample., Change from baseline in DaT-SPECT at 48 weeks and 100 weeks., Absolute values and change from baseline in the MDS-UPDRS Part III score over 100 weeks.

Source: https://euclinicaltrials.eu/ctis-public/view/2022-500292-31-00